EU clinical trial 2024-513177-48-00: A Phase 2 Study to Evaluate the Safety, Tolerability, and Efficacy of Regimens Containing VIR-2218, VIR-3434, and/or PEG-IFNα in Subjects with Chronic Hepatitis B Virus Infection
Protocol code: VIR-2218-1006
Sponsor: Vir Biotechnology Inc. (Pharmaceutical company). Phase: Therapeutic exploratory (Phase II). Countries: Romania (ended), Germany (ended).
Therapeutic area(s): Diseases [C] - Virus Diseases [C02]
Gender: Female, Male. Age: 18-64 years. Enrolment: 24.
Status: Ended. Start date (EU): 2022-06-16. End date (EU): 2024-10-01. End date: 2026-03-16. Decision date: 2024-09-18. Results received: No. Last updated: 2025-12-02.
Decision dates by country: DE: 2024-09-18, RO: 2024-09-23

Condition(s): Chronic Hepatitis B Virus Infection
Product: Vir-3434, Vir-2218, Pegasys 180 micrograms solution for injection in pre-filled syringe

Primary endpoint: • Proportion of subjects with treatment-emergent adverse events (TEAEs) • Proportion of subjects with serious adverse events (SAEs) • Proportion of subjects with HBsAg loss (defined as undetectable HBsAg) at end of treatment • Proportion of subjects with HBsAg loss (defined as undetectable HBsAg) at 24 weeks post-end of treatment
Endpoint(s): • Proportion of subjects achieving functional cure (defined as undetectable HBsAg and sustained suppression of HBV DNA [below the lower limit of quantification (< LLOQ), target not detected (TND)] for ≥ 24 weeks after discontinuation of all treatment, including NRTIs) • Proportion of subjects with serum HBsAg < 10 IU/mL at end of treatment • Proportion of subjects with serum HBsAg < 10 IU/mL at 24 weeks post-end of treatment, • Absolute serum HBsAg and change from baseline across timepoints in the study • Nadir and maximum reduction of serum of HBsAg from baseline • Time to achieve nadir of serum HBsAg • Time to achieve serum HBsAg loss • Proportion of subjects achieving sustained suppression of HBV DNA (< LLOQ for ≥ 24 weeks after discontinuation of all treatment, including NRTIs) • For HBeAg-positive subjects: proportion of subjects with HBeAg loss (undetectable HBeAg) and/or anti-HBe seroconversion, • For HBeAg-positive subjects: time to HBeAg loss (undetectable HBeAg) and/or anti-HBe seroconversion • Proportion of subjects with anti-HBs seroconversion • VIR-3434 PK parameters • Incidence and titers of anti-drug antibodies (ADA; if applicable) to VIR-3434 • Proportion of subjects meeting criteria for NRTI discontinuation • Proportion of subjects meeting criteria for NRTI retreatment

Source: https://euclinicaltrials.eu/ctis-public/view/2024-513177-48-00